EU clinical trial 2026-525871-24-00: Supplementary Oxygen Therapy after Limb Debridement and Reconstruction Surgery in Infected Extremity Fractures (SOLDIER): a pilot, non-blinded, randomized controlled trial
Protocol code: SOLDIER-2026
Sponsor: Amsterdam UMC Stichting (Patient organisation/association). Phase: Therapeutic exploratory (Phase II). Countries: Netherlands (authorised, recruitment pending).
Therapeutic area(s): Diseases [C] - Bacterial Infections and Mycoses [C01]; Diseases [C] - Musculoskeletal Diseases [C05]
Gender: Female, Male. Age: 18-64 years, 65+ years. Enrolment: 50.
Status: Authorised, recruitment pending. Decision date: 2026-06-22. Results received: No. Last updated: 2026-06-22.

Condition(s): Fracture-Related Infection
Product: OXYGEN

Primary endpoint: Number of subjects included after one year study duration, Number of HBOT sessions completed by each subject in the intervention group, Completeness of acquired data on patient-reported outcome measures

Source: https://euclinicaltrials.eu/ctis-public/view/2026-525871-24-00